EU clinical trial 2024-512767-30-00: CDX0159-08: A Phase 2 Randomized, Double-Blind, Placebo-Controlled Study to Assess the Efficacy and Safety of Barzolvolimab (CDX-0159) in Adults with Active Eosinophilic Esophagitis (The “EvolvE” Study)
Protocol code: CDX0159-08
Sponsor: Celldex Therapeutics Inc. (Pharmaceutical company). Phase: Therapeutic exploratory (Phase II). Countries: Spain (ended), Germany (ended), Poland (ended), Italy (ended).
Therapeutic area(s): Diseases [C] - Digestive System Diseases [C06]
Gender: Female, Male. Age: 18-64 years, 65+ years. Enrolment: 23.
Status: Ended. Start date (EU): 2023-09-28. End date (EU): 2025-09-17. Decision date: 2024-07-16. Results received: No. Last updated: 2025-06-01.
Decision dates by country: DE: 2024-07-16, PL: 2024-08-04, ES: 2024-07-16, IT: 2024-07-22

Condition(s): Eosinophilic Esophagitis
Product: FASTJEKT 300 Mikrogramm, Injektionslösung im Fertigpen, BARZOLVOLIMAB, Placebo matching CDX-0159, solution for injection

Primary endpoint: Absolute change from baseline to Week 12 in the PMC/high power field (hpf)
Endpoint(s): 1 - Absolute changes from baseline to Week 12 in DSQ, 2 - Absolute change from baseline to Week 12 in PMC/hpf among patients with baseline PMC ≥ 12/hpf, 3 - Absolute change from baseline to Week 12 in PEC/hpf, 4 - Percent (%) change from baseline to week 12 in PMC/hpf, 5 - Incidence of TEAEs

Source: https://euclinicaltrials.eu/ctis-public/view/2024-512767-30-00